EU clinical trial 2025-521738-27-00: A Phase II Randomized Clinical Trial Comparing Two Cycles Versus Four Cycles of Combination Therapy with Cetuximab, Avelumab, Cisplatin, and Docetaxel in Patients with Recurrent Metastatic Head and Neck Cancer - AVETUX-HN
Protocol code: MS062202_0168
Sponsor: Charite Universitaetsmedizin Berlin KöR (Hospital/Clinic/Other health care facility). Phase: Therapeutic exploratory (Phase II). Countries: Germany (ongoing, recruiting).
Therapeutic area(s): Diseases [C] - Otorhinolaryngologic Diseases [C09]; Diseases [C] - Neoplasms [C04]
Gender: Female, Male. Age: 18-64 years, 65+ years. Enrolment: 126.
Status: Ongoing, recruiting. Start date (EU): 2025-12-15. Decision date: 2025-11-17. Results received: No. Last updated: 2026-06-11.

Condition(s): Recurrent Metastatic Head and Neck Cancer
Product: CARBOPLATIN, CISPLATIN, Bavencio 20 mg/mL concentrate for solution for infusion, Erbitux 5 mg/mL solution for infusion, DOCETAXEL

Primary endpoint: Assessment of quality of life (QoL) regarding role functioning at 18 weeks after the initiation of treatment, measured by the standardized QLQ-C30 questionnaire.
Endpoint(s): Progression-Free Survival (PFS): PFS is defined as the time from the date of randomization to the date of the first documentation of objective disease progression or death due to any cause, whichever occurs first. To assess the difference between treatment arm A and treatment arm B in terms of progression-free survival (PFS), an exploratory analysis of the HR including a two-sided 95% CI will be carried out., Overall Survival (OS): OS is defined as the time from the date of randomization to the date of death due to any cause. To assess the difference between treatment arm A and treatment arm B in terms of overall survival (OS), an exploratory analysis of the HR including a two-sided 95% CI will be carried out., Objective Response Rate (ORR): ORR is defined as the proportion of patients who have a complete response (CR) or partial response (PR) according to RECIST 1.1 criteria. To assess the difference between treatment arm A and treatment arm B in terms of Objective Response Rate (ORR) an exploratory analysis of the HR including a two-sided 95% CI will be carried out., Duration of Response (DOR): DOR is defined as the time from the first documentation of response (CR or PR) to the date of the first documentation of disease progression or death due to any cause, whichever occurs first. To assess whether the difference between treatment arm A and treatment arm B in terms of Duration of Response an exploratory analysis of the HR including a two-sided 95% CI will be carried out., Exploratory: Quality of Life (QoL): Additional exploratory QoL assessments are conducted using other validated instruments to capture a broader range of patient-reported outcomes which will be assessed with EORTC QLQ H&N35., Exploratory: Perceived Stress Questionnaire (PSQ-20): The German version of the Perceived Stress Questionnaire (PSQ-20) by Fliege, Rose, Arck, Levenstein and Klapp (2001) was provided as an instrument for recording stress. The aim is to record the extent of the currently perceived stress factors and the experience of one's own stress on a cognitive and emotional level. It is not the source of the stress that should be stated, but the reaction to it. The factors worry, tension, joy and demands ar

Source: https://euclinicaltrials.eu/ctis-public/view/2025-521738-27-00